EU clinical trial 2025-520555-89-00: A Phase 3, Open-label, Multicenter, Randomized Study of Xaluritamig Plus Abiraterone Versus Investigator's Choice in Participants with Chemotherapy-naïve Metastatic Castration-resistant Prostate Cancer
Protocol code: 20230239
Sponsor: Amgen Inc. (Pharmaceutical company). Phase: Therapeutic confirmatory (Phase III). Countries: Austria (ongoing, recruiting), Netherlands (ongoing, recruiting), Portugal (ongoing, recruiting), Spain (ongoing, recruiting), Belgium (ongoing, recruiting), Greece (ongoing, recruiting), France (ongoing, recruiting), Italy (ongoing, recruiting), Germany (ongoing, recruiting).
Therapeutic area(s): Diseases [C] - Neoplasms [C04]
Gender: Male. Age: 18-64 years, 65+ years. Enrolment: 297.
Status: Ongoing, recruiting. Start date (EU): 2025-11-14. Decision date: 2025-11-03. Results received: No. Last updated: 2026-07-24.
Decision dates by country: ES: 2025-11-07, NL: 2025-11-04, FR: 2025-11-13, DE: 2025-11-06, AT: 2025-11-03, BE: 2025-11-03, GR: 2025-11-04, PT: 2025-11-06, IT: 2025-11-03

Condition(s): Metastatic castration-resistant prostate cancer (mCRPC)
Product: AMG 509, SYLVANT 400 mg powder for concentrate for solution for infusion, DOCETAXEL, ABIRATERONE ACETATE, ABIRATERONE ACETATE, AMG 509, ABIRATERONE ACETATE, CABAZITAXEL, ABIRATERONE ACETATE

Primary endpoint: Overall survival (OS)
Endpoint(s): rPFS per Prostate Cancer Working Group 3 (PCWG3)-modified Response Evaluation Criteria in Solid Tumors version 1.1 (RECIST 1.1), per investigator assessment, Objective response per modified RECIST 1.1, per investigator assessment, Duration of Response (DOR) per modified RECIST 1.1, per investigator assessment, Disease Control per modified RECIST 1.1, per investigator assessment, Progression-free survival (PFS) 2, per investigator assessment, Time to Response (TTR), per modified RECIST 1.1, per investigator assessment, Time to first subsequent therapy, Time to symptomatic skeletal events (SSE), Treatment-emergent adverse events, treatment-emergent serious adverse events, and fatal adverse events, Time to worsening as measured by: - BPI-SF Worst pain score - BPI-SF Pain intensity scale - BPI-SF Pain interference scale - FACT-P Total score, Time to improvement as measured by BPI-SF Worst pain score in participants with moderate/severe pain at baseline, Time to improvement after worsening as measured by BPI-SF Pain intensity scale score and BPI-SF Pain interference scale score, Patient-reported outcomes summary scores over time at each assessment as measured by: - Selected questions on symptomatic adverse events from the Patient-Reported Outcomes Version of the Common Terminology Criteria for Adverse Events (PRO-CTCAE) item library - The GP5 question on overall bother of side effects from the FACT-P questionnaire, Prostate-specific antigen (PSA) 50 and PSA 90 responses, Time to PSA 50 and PSA 90 responses, Duration of PSA 50 and PSA 90 response, Time to PSA progression, PK parameters for xaluritamig such as maximum serum concentration (Cmax), time to maximum concentration (Tmax), minimum serum concentration (Cmin), area under the concentration-time curve (AUC) over the dosing interval, accumulation following multiple dosing, and, if feasible, half-life (t1/2), Abiraterone PK concentrations at end of dosing interval, Incidence of anti-xaluritamig antibody formation, Change from baseline over time at each assessment as measured by: - BPI-SF Worst pain score - BPI-SF Pain intensity scale - BPI-SF Pain interference scale - FACT-P Total score and subscale scores - EQ-5D-5L Utility score - Change from baseline in the EQ-5D-5L Visual Analogue Scale (VAS)

Source: https://euclinicaltrials.eu/ctis-public/view/2025-520555-89-00